EU clinical trial 2023-510175-60-00: A 52-week, randomized, double-blind, placebo-controlled, parallel-group, study to evaluate the efficacy and safety of two doses of CHF6001 DPI add-on to maintenance triple therapy in subjects with Chronic Obstructive Pulmonary Disease (COPD) and Chronic Bronchitis.
Protocol code: CLI-06001AA1-04
Sponsor: Chiesi Farmaceutici S.p.A. (Pharmaceutical company). Phase: Therapeutic confirmatory (Phase III). Countries: Hungary (ended), Germany (ended), Slovakia (ended), Bulgaria (ended), Poland (ended), Romania (ended), Italy (ended), Greece (ended), Netherlands (ended), Spain (ended), Czechia (ended), Austria (ended).
Therapeutic area(s): Diseases [C] - Respiratory Tract Diseases [C08]
Gender: Female, Male. Age: 18-64 years, 65+ years. Enrolment: 1216.
Status: Ended. Start date (EU): 2021-06-16. End date (EU): 2025-06-18. End date: 2025-10-31. Decision date: 2024-08-21. Results received: No. Last updated: 2025-06-25.
Decision dates by country: AT: 2024-08-26, BG: 2024-09-11, CZ: 2024-08-22, DE: 2024-08-28, IT: 2024-09-24, RO: 2024-08-30, ES: 2024-08-26, NL: 2024-08-21, SK: 2024-08-21, PL: 2024-08-30, HU: 2024-08-21, GR: 2024-09-20

Condition(s): Chronic obstructive pulmonary disease (COPD) and Chronic Bronchitis
Product: CHF6001 DPI, CHF6001 DPI, Placebo to match CHF6001 DPI

Primary endpoint: Annual rate of moderate and severe exacerbations over 52 weeks.
Endpoint(s): •Change from baseline in SGRQ Total score at week 52 •Time to first moderate/severe exacerbation •Annual rate of severe exacerbations •Time to first severe exacerbation, •Change from baseline in morning pre-dose of FEV1 at week 52 •Change from baseline in SGRQ Domain scores at week 52, •SGRQ response (i.e., change from baseline in SGRQ score ≤ -4) at week 52 •Change from baseline to last inter-visit period (week 40-52) in the average E-RS total and sub-scale scores, •E-RS response (i.e., change from baseline in E-RS total score ≤ -2) at week 52 •Change from baseline to last inter-visit period (week 40-52) in the percentage of days without intake of rescue medication and in the average daily use of rescue medication (number of puffs/day), •Time to study medication discontinuation due to any reason •Time to first moderate or severe exacerbation or study medication discontinuation due to any adverse events, lack of efficacy or death (composite endpoint) and time to its individual components

Source: https://euclinicaltrials.eu/ctis-public/view/2023-510175-60-00